EU clinical trial 2025-523304-68-00: A research study to evaluate the safety of NNC1679-0001 when given to healthy participants and participants with T2DM
Protocol code: NN1679-8505
Sponsor: Novo Nordisk A/S (Pharmaceutical company). Phase: Human Pharmacology (Phase I)- First administration to humans. Countries: Austria (ongoing, recruiting).
Therapeutic area(s): Diseases [C] - Nutritional and Metabolic Diseases [C18]
Gender: Female, Male. Age: 18-64 years. Enrolment: 58.
Status: Ongoing, recruiting. Start date (EU): 2026-04-30. Decision date: 2026-04-19. Results received: No. Last updated: 2026-07-05.

Condition(s): Healthy participants and participants with type 2 diabetes

Source: https://euclinicaltrials.eu/ctis-public/view/2025-523304-68-00